EU clinical trial 2023-509290-22-00: Single antiplatelet treatment with Ticagrelor or Aspirin after Transcatheter Aortic Valve Implantation: multicenter randomized clinical trial
Protocol code: REAC-TAVI 2
Sponsor: Fundacion Biomedica Galicia Sur (Patient organisation/association). Phase: Therapeutic use (Phase IV). Countries: Spain (ongoing, recruiting), Italy (ongoing, recruiting), Portugal (authorised, recruitment pending).
Therapeutic area(s): Diseases [C] - Cardiovascular Diseases [C14]
Gender: Female, Male. Age: 18-64 years, 65+ years. Enrolment: 1200.
Start date (EU): 2022-01-21. Decision date: 2024-01-16. Results received: No. Last updated: 2026-06-30.
Decision dates by country: IT: 2024-08-13, PT: 2024-07-26, ES: 2024-01-16

Condition(s): Severe Symptomatic Aortic Stenosis
Product: Brilique 60 mg film-coated tablets, Adiro 100 mg comprimidos gastrorresistentes EFG

Primary endpoint: All-cause mortality at 12 months after TAVI, Transient ischemic attack (TIA) or stroke at 12 months after TAVI, Myocardial infarction at 12 months after TAVI, Bleeding at 12 months after TAVI according BARC, Net Adverse Clinical Event(s)
Endpoint(s): All major bleeding (type 2, 3 and 5) at 12 months after TAVI according BARC, Incidence of subclinical valve thrombosis (SVT) detected by hypoattenuated leaflet thickening (HALT) and reduced leaflet motion (RLM) at 3 and 12 months after TAVI assessed by 4-dimensional computed tomography (4DCT) imaging (performed only in pre-specified centers), Gender, Age, Valve type, Comorbilities, All-caused mortality at 12 months after TAVI, Stroke/TIA at 12 months after TAVI, Myocardial infarction at 12 months after TAVI, Progressive angina leading to emergency evaluation, rehospitalization or new coronary angiography at 12 months after TAVI, Thrombotic and bleeding risk score

Source: https://euclinicaltrials.eu/ctis-public/view/2023-509290-22-00